EU clinical trial 2024-518469-84-00: A Phase II, Open-Label, Multicenter, Master Protocol to Evaluate the Safety and Efficacy of Novel Study Interventions and Combinations in Participants with Colorectal Cancer (CANTOR)
Protocol code: D798VC00001
Sponsor: AstraZeneca AB (Pharmaceutical company). Phase: Therapeutic exploratory (Phase II). Countries: Spain (ongoing, recruiting), France (ongoing, recruiting), Netherlands (ongoing, recruiting), Italy (ongoing, recruiting), Germany (ongoing, recruiting).
Therapeutic area(s): Diseases [C] - Neoplasms [C04]
Gender: Female, Male. Age: 18-64 years, 65+ years. Enrolment: 69.
Status: Ongoing, recruiting. Start date (EU): 2025-06-20. Decision date: 2025-06-11. Results received: No. Last updated: 2026-02-25.
Decision dates by country: FR: 2025-06-13, DE: 2025-06-13, NL: 2025-06-11, IT: 2025-06-12, ES: 2025-06-13

Condition(s): Colorectal cancer
Product: INFLIXIMAB, FOLINIC ACID, IRINOTECAN HYDROCHLORIDE TRIHYDRATE, CALCIUM FOLINATE, MYCOPHENOLATE MOFETIL, volrustomig, FLUOROURACIL, BEVACIZUMAB

Primary endpoint: Master/Sub 1: • Incidence and severity of AEs/SAEs • Change from baseline in vital signs, clinical laboratory assessments, ECGs, ECOG performance status, and physical examination, Sub 1: PFS is defined as the time from randomization until progression per RECIST 1.1, or death due to any cause. The measure of interest is the difference in the PFS
Endpoint(s): Sub 1: OS is defined as the time from randomization until the date of death due to any cause. The measure of interest is the HR of OS, Sub 1: ORR is defined as the proportion of participants who have a confirmed CR or confirmed PR, as determined per RECIST 1.1. The measure of interest is the difference in ORR, Sub-1: DCR is defined as the percentage of participants who have a confirmed CR or PR or who have SD per RECIST 1.1. The measure of interest is the difference in DCR, DoR is defined as the time from the date of first documented confirmed response until date of documented progression per RECIST 1.1 or death due to any cause. The measure of interest is the difference in the median DoR, Sub 1: PFS2 is defined as the time from randomization to the earliest of the progression event, after first subsequent therapy, or death. The date of second progression will be recorded by the investigator in the eCRF and defined according to local standard clinical practice. The measure of interest is the HR of PFS2, Sub 1: Concentration of volrustomig in serum and PK parameters as data allow (such as peak and trough concentrations), Sub 1: Presence of ADAs against volrustomig in serum (confirmatory results: positive or negative, titers)

Source: https://euclinicaltrials.eu/ctis-public/view/2024-518469-84-00